EU clinical trial 2022-502483-21-00: Efficacy and tolerability of tasipimidine after 3 repeated bed-time doses in patients with insomnia disorder with a 4-week extension part
Protocol code: 3110012
Sponsor: Orion Corporation (Pharmaceutical company). Phase: Therapeutic exploratory (Phase II). Countries: Finland (ended), Poland (ended), Germany (ended).
Therapeutic area(s): Diseases [C] - Nervous System Diseases [C10]
Gender: Female, Male. Age: 18-64 years, 65+ years. Enrolment: 272.
Status: Ended. Start date (EU): 2023-07-28. End date (EU): 2025-09-24. End date: 2025-09-25. Decision date: 2023-05-24. Results received: No. Last updated: 2025-10-31.
Decision dates by country: FI: 2023-05-24, PL: 2023-05-29, DE: 2024-07-17

Condition(s): Insomnia disorder
Product: ODM-105 0.3 mg/ml oral solution, ODM-105 0.05 mg/ml oral solution, ODM-105 placebo oral solution

Primary endpoint: Wake after sleep onset (WASO) assessed with polysomnography (PSG) for Day 1 and Day 2 data combined from Part 1 and Part 2, Latency to persistent sleep (LPS) assessed with polysomnography (PSG) for Day 1 and Day 2 data combined from Part 1 and Part 2
Endpoint(s): Adverse events (AEs), Heart rate (HR), Diastolic blood pressure (DBP), Systolic blood pressure (SBP), Mean arterial pressure (MAP), Orthostatic changes in blood pressure (BP), Morning sleepiness, Safety laboratory tests, Pharmacokinetic (PK) variables, WASO and LPS assessed with PSG for Day 1 and Day 2 data separately from Part 1 and Part 2; in Part 2 WASO and LPS assessed with PSG for Day 27 and Day 28

Source: https://euclinicaltrials.eu/ctis-public/view/2022-502483-21-00